EU clinical trial 2024-516374-29-00: SHORT RUN AF. Rivaroxaban versus standard of care for patients with excessive atrial ectopy or short atrial runs and high embolism risk
Protocol code: APHP200002
Sponsor: Assistance Publique Hopitaux De Paris (Hospital/Clinic/Other health care facility). Phase: Phase III and phase IV (Integrated). Countries: France (ended).
Therapeutic area(s): Diseases [C] - Cardiovascular Diseases [C14]
Gender: Female, Male. Age: 65+ years. Enrolment: 550.
Status: Ended. Start date (EU): 2023-04-18. End date (EU): 2025-08-28. Decision date: 2024-10-04. Results received: No. Last updated: 2024-10-04.

Condition(s): Patients with excessive supraventricular ectopies or short atrial runs (ESVEA) defined as ≥ 1% premature atrial contractions (PAC) /24 hours or any atrial runs ≥ 20 PACs (but shorter than 30 seconds) on a 24-hour Holter ECG monitoring and CHA2DS2VASC score ≥ 3. Patients with any atrial runs ≥ 20 PACs but shorter than 30 seconds on a 15-21 days Holter ECG monitoring and CHA2DS2VASC score ≥ 3 may also be included in the Short-Run trial.
Product: RIVAROXABAN, RIVAROXABAN, RIVAROXABAN

Primary endpoint: The primary efficacy endpoint is the first ischemic stroke or peripheral embolism detected clinically and on systematic cerebral MRIs in a time-to-event analysis., The primary safety outcome is major bleeding at any site in the body according to the criteria of the International Society of Thrombosis and Hemostasis (ISTH)(23-25).
Endpoint(s): Efficacy-related endpoints: o A composite of ischemic stroke, peripheral embolism or major bleeding (net clinical benefit); a composite of death from cardiovascular causes, stroke, systemic embolism, myocardial infarction (major cardiovascular events); death from any cause; cognitive decline as assessed by the MMS (26). o Individual components of composite primary and secondary efficacy endpoints, Exploratory endpoints: o Incidence of documented atrial fibrillation diagnosed from patient symptoms or systematic 24 hours ECG Holter performed at 1- and 2-year follow-up. o Incidence of asymptomatic MRI-detected cerebral damage including silent cerebral ischemia and microbleeds at 2-year follow up., Safety-related endpoints: o Life-threatening or fatal bleeding events, clinically relevant non-major bleeding intracranial hemorrhage and minor bleeding events. Bleeding severity will be assessed according to ISTH classification.

Source: https://euclinicaltrials.eu/ctis-public/view/2024-516374-29-00